EU clinical trial 2022-500495-65-00: B7841008 - AN OPEN-LABEL STUDY IN PEDIATRIC (<18 YEARS OF AGE), SEVERE HEMOPHILIA A PARTICIPANTS (COAGULATION FACTOR ACTIVITY <1%) WITH OR WITHOUT INHIBITORS OR MODERATELY SEVERE TO SEVERE HEMOPHILIA B PARTICIPANTS (COAGULATION FACTOR ACTIVITY ≤2%) WITH OR WITHOUT INHIBITORS COMPARING 12 MONTHS OF HISTORICAL STANDARD TREATMENT TO MARSTACIMAB PROPHYLAXIS
Protocol code: B7841008
Sponsor: Pfizer Inc. (Pharmaceutical company). Phase: Therapeutic confirmatory (Phase III). Countries: Italy (ongoing, recruiting), Czechia (ongoing, recruiting), Germany (ended), France (ended), Denmark (ongoing, recruiting), Austria (ongoing, recruiting), Spain (ongoing, recruiting), Slovakia (ongoing, recruiting).
Therapeutic area(s): Diseases [C] - Hemic and Lymphatic Diseases [C15]
Gender: Male. Age: 0-17 years. Enrolment: 22.
Start date (EU): 2023-12-06. Decision date: 2023-04-19. Results received: No. Last updated: 2026-07-29.
Decision dates by country: FR: 2023-04-19, IT: 2023-04-20, ES: 2023-04-24, DE: 2023-04-20, DK: 2023-04-19, AT: 2023-04-24, CZ: 2023-04-21, SK: 2023-04-21

Condition(s): Haemophilia
Product: Marstacimab

Primary endpoint: The primary efficacy endpoint is the ABR of treated bleeding events., Safety Endpoints:•AEs and SAEs •Incidence and severity of thrombotic events •Incidence and severity of thrombotic microangiopathy •Disseminated intravascular coagulation/consumption coagulopathy •Immunogenicity (incidence of ADA and clinically significant persistent NAb against marstacimab) •Incidence and severity of injection site reaction •Incidence of severe hypersensitivity and anaphylactic reactions
Endpoint(s): The following parameters will be assessed: •Incidence of joint bleeds (treated) •Incidence of spontaneous bleeds (treated) •Incidence of target joint bleeds (treated) •Incidence of total bleeds (treated and untreated) •Number of target joints •Change from baseline in joint health as measured by the HJHS for participants ≥4 years of age, HRQoL: •Haem-A-QoL (≥17 years of age)/Haemo-QoL (age-dependent versions ≥12 to <17 years of age and 8 to <12 years of age) •pedHAL (children/teenager version 8 to ≤17 years of age, parent proxy version 4 to <8 years of age) •PGIC-H for participants ≥4 years of age •Health Utilities Measure (EQ-5D-Y) for participants ≥4 years of age

Source: https://euclinicaltrials.eu/ctis-public/view/2022-500495-65-00